EU clinical trial 2024-513914-36-00: RADIANCE Radiochemotherapy +/- Durvalumab for locally-advanced Anal Carcinoma; A multicenter, randomized, phase II trial of the German Anal Cancer Study Group
Protocol code: RADIANCE
Sponsor: Goethe University Frankfurt (Educational Institution). Phase: Therapeutic exploratory (Phase II). Countries: Austria (ongoing, recruitment ended), Germany (ongoing, recruitment ended).
Therapeutic area(s): Diseases [C] - Neoplasms [C04]
Gender: Female, Male. Age: 18-64 years, 65+ years. Enrolment: 180.
Status: Ongoing, recruitment ended. Start date (EU): 2019-12-17. Decision date: 2024-08-01. Results received: No. Last updated: 2026-02-27.
Decision dates by country: AT: 2024-08-22, DE: 2024-08-01

Condition(s): locally-advanced Anal Carcinoma, Anal cancer stage II and III
Product: IMFINZI 50 mg/mL concentrate for solution for infusion.

Primary endpoint: disease free survival
Endpoint(s): Acute and late toxicity according to Common Terminology Criteria for Adverse Events (CTCAE) v5.0, Treatment compliance and safety, Complete clinical response rate assessed 26 weeks after initiation of RCT (defined by re-staging MRI and proctoscopy, including biopsies of suspicious findings), Overall survival (OS, defined as the time between randomization and death from any cause), Colostomy-free survival, Cumulative incidence of locoregional and distant recurrences, Quality of Life according to EORTC QLQ–C30 (version 3.0) and functional outcome per EORTC ANL27, Value of various MRI sequences, including diffusion-weighted MRI, for prediction and monitoring of treatment response, Translational / biomarker studies

Source: https://euclinicaltrials.eu/ctis-public/view/2024-513914-36-00